EU clinical trial 2024-511337-35-00: Prospective phase I/II trial of an individualized peptide vaccine in pediatric and AYA patients with metastasized fusion-driven sarcomas following standard treatment
Protocol code: PerVision
Sponsor: Universitaetsklinikum Tuebingen AöR (Hospital/Clinic/Other health care facility). Phase: Therapeutic exploratory (Phase II). Countries: Germany (authorised, recruiting).
Therapeutic area(s): Diseases [C] - Neoplasms [C04]
Gender: Female, Male. Age: 0-17 years, 18-64 years. Enrolment: 23.
Status: Authorised, recruiting. Start date (EU): 2023-11-16. Decision date: 2024-10-14. Results received: No. Last updated: 2025-11-11.

Condition(s): The trial will include patients with so called "fusion-driven", metastatic sarcomas of the following types: - Ewing sarcoma, - alveolar rhabdomyosarcoma; - or synovial sarcoma who are in first or second complete remission or partial response
Product: IPX vaccine

Primary endpoint: Primary endpoint is "success of treatment", defined as the patient showing a vaccination-induced T cell response to either of the two patient specific peptides without unacceptable toxicity until Follow-up visit (28 ± 7 days after last vaccination)
Endpoint(s): A) CD8+ and/or CD4+ T-cell responses measured 2-fold above background in response to either of the two patient-specific peptides (fusion-peptide and mutation-based neopeptide)., B)CD8+ and/or CD4+ T-cell responses measured 2-fold above background in response to either of the two patient-specific peptides after completion of the study at day 180., C) Event-free (EFS) at day 180., D) Overall survival (OS) at day 180, E) Quality of life during study treatment.

Source: https://euclinicaltrials.eu/ctis-public/view/2024-511337-35-00